EU clinical trial 2024-519052-82-00: IFCT-2403 BI-MAPS Assessment of ivonescimab as salvage treatment in relapsing pleural mesothelioma patients, previously treated by immunotherapy and standard chemotherapy
Sponsor: Intergroupe Francophone De Cancerologie Thoracique (Patient organisation/association). Phase: Therapeutic exploratory (Phase II). Countries: France (ongoing, recruiting).
Therapeutic area(s): Diseases [C] - Neoplasms [C04]
Gender: Female, Male. Age: 18-64 years, 65+ years. Enrolment: 38.
Status: Ongoing, recruiting. Start date (EU): 2025-06-30. Decision date: 2025-04-04. Results received: No. Last updated: 2026-06-22.

Condition(s): pleural mesothelioma
Product: ivonescimab

Primary endpoint: Disease control rate (DCR) at 12 weeks, according to RECIST 1.1 criteria modified for mesothelioma, as assessed by an Independent Review Committee (IRC) of 3 expert thoracic radiologists and oncologists
Endpoint(s): Incidence, nature and severity of AEs, graded according to the National Cancer Institute Common Terminology Criteria for Adverse Events, version 5.0 (NCI CTCAE v5.0), Progression free survival (PFS) as assessed by an IRC of 3 expert thoracic radiologists and oncologists, PFS as assessed by the local investigator, PFS according to previous immunotherapy versus no previous immunotherapy, PFS according to the histological subtype epithelioid vs. non-epithelioid, Overall survival (OS), Best response rate, Duration of response (DOR)

Source: https://euclinicaltrials.eu/ctis-public/view/2024-519052-82-00